EU clinical trial 2023-507738-26-00: A Modular Open-Label, Multi-Centre Phase 1/2 Dose-Finding, Optimisation, and Expansion Study to Evaluate the Safety, Tolerability, Pharmacokinetics, and Efficacy of EP0062 as monotherapy and in combination in Patients with Relapsed Locally Advanced or Metastatic AR+/HER2-/ER+ Breast Cancer
Protocol code: EP0062-101
Sponsor: Ellipses Pharma Limited (Pharmaceutical company). Phase: Phase I and Phase II (Integrated)- Other. Countries: Spain (ongoing, recruiting).
Therapeutic area(s): Diseases [C] - Neoplasms [C04]
Gender: Female. Age: 18-64 years, 65+ years. Enrolment: 25.
Status: Ongoing, recruiting. Start date (EU): 2024-03-20. Decision date: 2024-01-26. Results received: No. Last updated: 2026-08-04.

Condition(s): Breast Cancer
Product: ORSERDU 345 mg film-coated tablets, EP0062, ORSERDU 86 mg film-coated tablets

Primary endpoint: 1. Module A: Incidence of dose-limiting toxicities (DLTs) during Cycle 1 of EP0062 treatment (28 days), 2. Module A: Incidence and severity of adverse events (AEs) and serious adverse events (SAEs), 3. Module A: Optimal monotherapy dose and a clinical dose for evaluation in the combination arms of Module B, 4. Module B: Incidence and severity of AEs and SAEs, 5. Module B: Recommended clinical dose(s) for combination therapy
Endpoint(s): 1. Module A: Plasma PK parameters AUC0–48, AUClast, AUCinf, Cmax and/or Cmin, tmax, t½, CL/F, V/F, and/or Vz/F, 2. Module A: Objective response rate (ORR), 3. Module A: Duration of response (DOR), 4. Module A: Progression-free survival (PFS), 5. Module A: Clinical benefit rate (CBR), 6. Module A: Overall survival (OS), 7. Module A: PD response to EP0062, 8. Module B: Plasma PK parameters of EP0062 AUC0–24, AUClast, AUCinf, Cmax and/or Cmin, tmax, t½, CL/F, V/F, and/or Vz/F, 9. Module B: ORR, 10. Module B: DOR, 11. Module B: PFS, 12. Module B: CBR, 13. Module B: OS

Source: https://euclinicaltrials.eu/ctis-public/view/2023-507738-26-00